EU clinical trial 2022-502526-41-00: A Phase II Clinical Trial to Study the Efficacy and Safety of Pembrolizumab (MK-3475) and Pembrolizumab in Combination with Other Investigational Agents in Subjects with High-risk Non-muscle-Invasive Bladder Cancer (NMIBC) Unresponsive to Bacillus Calmette-Guerin (BCG) Therapy
Protocol code: MK-3475-057
Sponsor: Merck Sharp & Dohme LLC (Pharmaceutical company). Phase: Therapeutic exploratory (Phase II). Countries: Finland (ended), Greece (ended), Netherlands (ended), Sweden (ended), Spain (ended), France (ended), Italy (ended).
Therapeutic area(s): Diseases [C] - Neoplasms [C04]
Gender: Female, Male. Age: 18-64 years, 65+ years. Enrolment: 102.
Status: Ended. Start date (EU): 2016-03-15. End date (EU): 2025-11-05. End date: 2025-11-06. Decision date: 2023-07-13. Results received: No. Last updated: 2025-09-08.
Decision dates by country: SE: 2023-07-13, GR: 2023-07-13, NL: 2023-07-13, FR: 2023-08-04, ES: 2023-07-18, FI: 2023-07-13, IT: 2023-08-04

Condition(s): Non-Muscle Invasive Bladder Cancer (NMIBC)
Product: MK-7684A, KEYTRUDA 25 mg/mL concentrate for solution for infusion, MK-4280A

Primary endpoint: Cohort A: Complete Response (CR) Rate of High-Risk Non-Muscle Invasive Bladder Cancer (NMIBC), Cohort B: 12-month Disease-Free Survival (DFS) Rate of High-Risk NMIBC, Cohort A and B: Number of Participants Who Experience an Adverse Event (AE), Cohort A and B: Number of Participants Who Discontinue Study Treatment Due to an AE
Endpoint(s): Cohort A: CR Rate of Any Disease, Cohort A: CR Rate of High-Risk NMIBC in Programmed Cell Death 1 (PDL-1) Positive Participants, Cohort A: Duration of Response (DOR), Cohort A and B: Progression-Free Survival (PFS), Cohort A and B: Overall Survival (OS), Cohort B: DFS Rate of Any Disease, Cohort B: 12-month DFS Rate of Any Disease, Cohort B: 12-month DFS Rate of High-Risk NMIBC in PDL-1 Positive Participants

Source: https://euclinicaltrials.eu/ctis-public/view/2022-502526-41-00